EU clinical trial 2025-520619-15-00: Efficacy of Bilateral Greater Occipital Nerve Block as a Treatment for Headache Secondary to Spontaneous Subarachnoid Hemorrhage
Sponsor: Fundacio Institut De Recerca De L'Hospital De La Santa Creu I Sant Pau (Hospital/Clinic/Other health care facility). Phase: Therapeutic exploratory (Phase II). Countries: Spain (ongoing, recruiting).
Therapeutic area(s): Analytical, Diagnostic and Therapeutic Techniques and Equipment [E] - Anesthesia and Analgesia [E03]; Diseases [C] - Nervous System Diseases [C10]; Diseases [C] - Pathological Conditions, Signs and Symptoms [C23]; Analytical, Diagnostic and Therapeutic Techniques and Equipment [E] - Therapeutics [E02]
Gender: Female, Male. Age: 18-64 years, 65+ years. Enrolment: 40.
Status: Ongoing, recruiting. Start date (EU): 2025-07-11. Decision date: 2025-05-23. Results received: No. Last updated: 2025-06-19.

Condition(s): headache pain related to SAH, Spontaneous subarachnoid hemorrhage
Product: Lidocaína B. Braun 20 mg/ml solución inyectable, Suero Fisiológico Braun 0,9% disolvente para uso parenteral Cloruro de sodio

Primary endpoint: Composite variable consisting of headache reduction measured with the Numerical Pain Rating Scale (NPRS) at 1 hour post-procedure, defined as a ≥30% reduction (partial response) or ≥50% reduction (optimal effect) as dichotomous variables (yes/no; n, %), and/or the absence of headache within the first hour after the procedure.

Source: https://euclinicaltrials.eu/ctis-public/view/2025-520619-15-00